EU clinical trial 2022-502003-30-00: STOP-COPD Standard vs Targeted Oxygen Therapy Prehospital for Chronic Obstructive Pulmonary Disease
Sponsor: Præhospitalet (Hospital/Clinic/Other health care facility). Phase: Therapeutic use (Phase IV). Countries: Denmark (ongoing, recruiting).
Therapeutic area(s): Diseases [C] - Respiratory Tract Diseases [C08]
Gender: Female, Male. Age: 18-64 years, 65+ years. Enrolment: 1888.
Status: Ongoing, recruiting. Start date (EU): 2024-12-11. Decision date: 2022-12-06. Results received: No. Last updated: 2024-12-26.

Condition(s): Acute Exacerbation of Chronic Obstructive Pulmonary Disease
Product: Berodual, inhalationsvæske til nebulisator, opløsning, Salbutamol ”TEVA”, inhalationsvæske til nebulisator, opløsning, Medicinsk Luft ”Air Liquide” 100%, medicinsk gas, komprimeret, Medicinsk Oxygen ”Air Liquide” 100 %, medicinsk gas komprimeret

Primary endpoint: 30-day mortality
Endpoint(s): 24-hour mortality, 7-day mortality, Length of hospitalization, ICU admission rate, Length of ICU admission, In-hospital need for NIV within 24 hours, 7 days and 30 days, Time to NIV, In-hospital need for invasive mechanical ventilation within 24 hours, 7 days and 30 days, Time to invasive ventilation, Proportion of patients with respiratory acidosis on arrival to hospital, The degree of acidosis based on the pH-value, Patient experienced dyspnoea on a verbal rating scale 0-10, Readmission rate, Time to readmission

Source: https://euclinicaltrials.eu/ctis-public/view/2022-502003-30-00